EU clinical trial 2024-512869-14-00: CYMEVALIII - Prenatal treatment of congenital cytomegalovirus infection with letermovir randomized against valaciclovir (CYMEVAL) III
Protocol code: APHP180592
Sponsor: Assistance Publique Hopitaux De Paris (Hospital/Clinic/Other health care facility). Phase: Therapeutic confirmatory (Phase III). Countries: France (ongoing, recruitment ended).
Therapeutic area(s): Diseases [C] - Virus Diseases [C02]
Gender: Female. Age: 18-64 years. Enrolment: 46.
Status: Ongoing, recruitment ended. Start date (EU): 2024-07-22. Decision date: 2024-07-22. Results received: No. Last updated: 2026-04-13.

Condition(s): Diseases [C] - Virus Diseases [C02]
Product: VALACICLOVIR ARROW 500 mg, comprimé pelliculé sécable, PREVYMIS PLACEBO, VALACICLOVIR PLACEBO, PREVYMIS 240 mg film-coated tablets

Primary endpoint: Negative CMV PCR (<500 IU/ml) in neonatal blood collected in the first day of life or in cord blood at termination of pregnancy
Endpoint(s): Secondary objectives: (step 2) The following are to be compared between the 2 arms: -Proportion of asymptomatic neonates -Overall growth -Proportion of long-term sequelae at 2 years -Tolerance of treatment for mothers, fetuses and neonates -Adherence to treatment -Evolution of ultrasound features between Day0 and Week 2, Week 4, and Week 6 of treatment -Changes in cerebral and placental features between Day 1st magnetic resonance imaging (MRI) within the first month of inclusion and 2nd MR

Source: https://euclinicaltrials.eu/ctis-public/view/2024-512869-14-00